EU clinical trial 2024-511890-30-03: Frozen-thawed embryo transfer in a natural versus artificial cycle: a randomized clinical trial.
Sponsor: UZ Leuven (Hospital/Clinic/Other health care facility). Phase: Therapeutic use (Phase IV). Countries: Belgium (ongoing, recruitment ended).
Therapeutic area(s): Diseases [C] - Female Urogenital Diseases and Pregnancy Complications [C13]
Gender: Female. Age: 18-64 years. Enrolment: 554.
Status: Ongoing, recruitment ended. Start date (EU): 2018-06-26. Decision date: 2025-01-22. Results received: No. Last updated: 2025-01-22.

Condition(s): Subfertility
Product: Progynova 2 mg dragerade tabletter, Utrogestan 200 mg capsule molli vaginali

Primary endpoint: Clinical pregnancy rate with fetal heart beat
Endpoint(s): Biochemical pregnancy rate, miscarriage rate, ectopic pregnancy rate, live birth rate, multiple pregnancy rate, adverse events, cycle cancellation rate, endometrial thickness, endometrial pattern, number of center visits to monitor FET cycle, cost analysis per cycle, patient satisfaction, Obstetrical outcomes in case of pregnancy: gestational age, birth weight, incidence of pregnancy- induced hypertension, pre-eclampsia, placenta previa, placenta accrete/increta/percreta, abruptio placentae, postpartum hemorrhage (early, late)

Source: https://euclinicaltrials.eu/ctis-public/view/2024-511890-30-03